EU clinical trial 2025-520977-37-00: Intubation Conditions in Morbidly Obese Patients with Rapid Sequence Induction: A Comparative Study of Rocuronium Dosing based on Ideal vs. Real Body Weight
Sponsor: UZ Brussel (Hospital/Clinic/Other health care facility). Phase: Therapeutic use (Phase IV). Countries: Belgium (not authorised).
Therapeutic area(s): Analytical, Diagnostic and Therapeutic Techniques and Equipment [E] - Anesthesia and Analgesia [E03]
Gender: Female, Male. Age: 18-64 years, 65+ years. Enrolment: 182.
Status: Not authorised. Decision date: 2025-11-12. Results received: No. Last updated: 2025-11-12.

Condition(s): Obesity
Product: NaCl 0,9 % B. Braun, Injektionslösung, Propofol B. Braun 1% (10 mg/ml), emulsie voor injectie of infusie, Rocuroniumbromide Fresenius Kabi 10 mg/ml oplossing voor injectie / infusie

Primary endpoint: Achievement of excellent intubation conditions during Rapid Sequence Induction in morbidly obese patients through the administration of rocuronium based on Ideal Body Weight or Real Body Weight.
Endpoint(s): Proportion of patients achieving clinically acceptable intubation conditions, defined as excellent or good according to the Fuchs–Borgeat scale, during rapid sequence induction (RSI) following rocuronium administration based on IBW or RBW., Time to successful endotracheal intubation, measured from the start of rocuronium injection (flushing of the IV line) until confirmation of intubation by the first capnography trace consistent with endotracheal placement., Neuromuscular blockade level at intubation, assessed by train-of-four (TOF) response 45 seconds after flushing of the IV line, Use of adjunctive maneuvers or techniques (e.g., external laryngeal manipulation, use of bougie) required to improve the glottic view during intubation., Use of additional maneuvers or techniques to improve glottis view, Oxygenation, defined by peripheral oxygen saturation (SpO₂): prior to pre-oxygenation, after pre-oxygenation, the lowest SpO₂ value observed during the intubation process, Incidence and nature of adverse events occurring during RSI, including: respiratory events (e.g., desaturation, bronchospasm), hemodynamic events (e.g., hypo- or hypertension),

Source: https://euclinicaltrials.eu/ctis-public/view/2025-520977-37-00